EU clinical trial 2024-512805-18-00: A study to test different doses of BI 1823911 alone and combined with other medicines in people with different types of advanced cancer with KRAS mutation.
Protocol code: 1472-0001
Sponsor: Boehringer Ingelheim International GmbH (Pharmaceutical company). Phase: Human Pharmacology (Phase I)- Other. Countries: Spain (ended), Belgium (ended).
Therapeutic area(s): Diseases [C] - Neoplasms [C04]
Gender: Female, Male. Age: 18-64 years, 65+ years. Enrolment: 25.
Status: Ended. Start date (EU): 2021-08-03. End date (EU): 2025-10-22. Decision date: 2024-06-25. Results received: No. Last updated: 2025-06-13.
Decision dates by country: BE: 2024-06-25, ES: 2024-06-26

Condition(s): solid tumour harbouring G12C mutation

Source: https://euclinicaltrials.eu/ctis-public/view/2024-512805-18-00